EU clinical trial 2024-517868-33-00: Phase 2 Study of Zelenectide Pevedotin in Participants with NECTIN4 Amplified Advanced Breast Cancer
Protocol code: BT8009, Duravelo-3
Sponsor: Bicycletx Limited (Pharmaceutical company). Phase: Therapeutic exploratory (Phase II). Countries: Spain (ongoing, recruitment ended), Belgium (ongoing, recruitment ended), Italy (ongoing, recruitment ended), France (ongoing, recruitment ended).
Therapeutic area(s): Diseases [C] - Neoplasms [C04]
Gender: Female, Male. Age: 18-64 years, 65+ years. Enrolment: 30.
Status: Ongoing, recruitment ended. Start date (EU): 2025-06-12. Decision date: 2025-06-03. Results received: No. Last updated: 2026-07-31.
Decision dates by country: BE: 2025-06-04, FR: 2025-06-03, ES: 2025-06-03, IT: 2025-06-06

Condition(s): NECTIN4 Amplified Advanced Breast Cancer
Product: BT8009, Zelenectide Pevedotin

Primary endpoint: ORR measured by the percentage of participants who have achieved either a confirmed complete response (CR) or partial response (PR) per RECIST v1.1 assessed by the investigator.
Endpoint(s): Incidence, severity, seriousness, relationship, and type of adverse events (AEs) and abnormalities in laboratory, electrocardiogram (ECG), vital signs, and treatment modifications., DoR measured by the time from first documentation of objective response (that is subsequently confirmed) per RECIST v1.1 assessed by the Investigator to the first documentation of disease progression (per RECIST v1.1), assessed by the Investigator, or to death (due to any cause), whichever occurs first., DCR measured by the percentage of participants who experience a confirmed CR, PR, or stable disease (SD) per RECIST v1.1 assessed by the Investigator., CBR, defined as the proportion of participants with CR, PR or SD ≥16 weeks per RECIST v1.1 assessed by the Investigator, PFS measured by the time from the first day of study drug administration (Day 1) to the first documentation of disease progression (per RECIST v1.1), assessed by the Investigator, or to death (due to any cause), whichever occurs first., OS measured by length of time from the first day of study drug administration (Day 1) to death (due to any cause)., TTP defined as the time from first dose of zelenectide pevedotin until first documentation of disease progression per RECIST v.1.1 assessed by the Investigator, Please refer to the clinical study protocol for all End Points.

Source: https://euclinicaltrials.eu/ctis-public/view/2024-517868-33-00